EU clinical trial 2023-503343-33-00: C0251013 - A PHASE 2, DOUBLE-BLIND, RANDOMIZED, PLACEBO-CONTROLLED, MULTICENTER STUDY TO EVALUATE THE CLINICAL EFFECT, PHARMACODYNAMIC, PHARMACOKINETIC AND SAFETY PROFILE OF PF-06823859 IN ADULT PARTICIPANTS WITH ACTIVE CLE OR SLE WITH CUTANEOUS MANIFESTATIONS
Protocol code: C0251013
Sponsor: Pfizer Inc. (Pharmaceutical company). Phase: Therapeutic exploratory (Phase II). Countries: Spain (ended), Greece (ended).
Therapeutic area(s): Diseases [C] - Immune System Diseases [C20]; Diseases [C] - Skin and Connective Tissue Diseases [C17]
Gender: Female, Male. Age: 18-64 years, 65+ years. Enrolment: 10.
Status: Ended. Start date (EU): 2023-12-21. End date (EU): 2025-10-08. End date: 2025-11-18. Decision date: 2023-10-02. Results received: No. Last updated: 2025-10-10.
Decision dates by country: ES: 2023-10-02, GR: 2023-10-02

Condition(s): Active Cutaneous Lupus Erythematosus (CLE) or Systemic Lupus Erythematosus (SLE) With Cutaneous Manifestations
Product: PF-06823859, Placebo for PF-06823859

Primary endpoint: Change from baseline in type 1 IFN GS score in lesional skin at Week 12
Endpoint(s): Change from baseline (%) in CLASI A score at Week 12, Percent change from baseline in CLASI-A (over time in addition to Week 12). Change from baseline in CLASI-A (over time). Achieving ≥50%, 4 or 7 points reduction in CLASI-A (over time), Change from baseline in PhGA (over time), Incidence and severity of laboratory, vital signs, 12-lead ECG abnormalities, AEs, SAEs and withdrawals due to AEs over time

Source: https://euclinicaltrials.eu/ctis-public/view/2023-503343-33-00